EU clinical trial 2024-511626-30-00: MEtformin as a MEtabolic iNTervention in Oesophageal adenocarcinomas to improve response to neoadjuvant chemoradiotherapy
Protocol code: MEMENTO
Sponsor: Amsterdam UMC Stichting (Hospital/Clinic/Other health care facility). Phase: Therapeutic exploratory (Phase II). Countries: Netherlands (ongoing, recruiting).
Therapeutic area(s): Diseases [C] - Neoplasms [C04]
Gender: Female, Male. Age: 18-64 years, 65+ years. Enrolment: 14.
Status: Ongoing, recruiting. Start date (EU): 2025-03-09. Decision date: 2024-08-05. Results received: No. Last updated: 2025-10-21.

Condition(s): Oesophageal adenocarcinoma
Product: Metformin Aurobindo 500 mg film-coated tablets

Primary endpoint: Metabolic switch in macrophages measured by M2 to M1 macrophage polarization within the tumour immune microenvironment and the number of CD8 intratumoral T-cell infiltration determined with single cell mRNA sequencing.
Endpoint(s): Measure changes in T cell infiltration and the CD3:CD163 ratio within the spatial context by multicolor immunohistochemistry (mIHC)., Detect metabolic changes in macrophages and T cells in the tumour immune microenvi-ronment by SCENITH flow cytometry analysis., Pathological response according to pTNM stage and Mandard criteria, Adverse events based on Common Toxicity Criteria for Adverse Events (CTCAE)., Progression free survival, Overall survival

Source: https://euclinicaltrials.eu/ctis-public/view/2024-511626-30-00